EU clinical trial 2023-508709-26-00: F-18 PSMA-11 PET for Imaging and Staging of Hepatocellular carcinoma with Evaluation of Survival
Protocol code: FISHES
Sponsor: Universitair Ziekenhuis Gent (Hospital/Clinic/Other health care facility). Phase: Therapeutic exploratory (Phase II). Countries: Belgium (ongoing, recruiting).
Therapeutic area(s): Diseases [C] - Neoplasms [C04]
Gender: Female, Male. Age: 18-64 years, 65+ years. Enrolment: 32.
Status: Ongoing, recruiting. Start date (EU): 2026-07-31. Decision date: 2024-08-23. Results received: No. Last updated: 2026-06-24.

Condition(s): Hepatocellular carcinoma
Product: [18F]PSMA-11

Primary endpoint: Per-lesion detection rate of F-18 PSMA-11 PET/CT, 60-90 minutes post-injection.
Endpoint(s): Overall Survival (OS) and Progression-Free Survival (PFS): Measured among subjects with PSMA-avid, FDG-avid, and Choline-avid HCC lesions, measured after completion of the 2 year follow-up for all patients., Tumor-to-Background Ratio: Assessed for intrahepatic HCC lesions 60-90 minutes post-injection using F-18 PSMA-11 PET/CT., Standard Uptake Value (SUV) Parameters: Analyzed for all HCC lesions detected 60-90 minutes post-injection with F-18 PSMA-11 PET/CT., Proportion of subjects with Metastatic HCC: Comparison between those detected by F-18 PSMA-11 PET/CT, F-18 FDG PET, and F-18 Choline PET, 60-90 minutes post-injection.

Source: https://euclinicaltrials.eu/ctis-public/view/2023-508709-26-00